EU clinical trial 2023-506626-37-00: Evaluation of the efficacy and safety of dual biological therapy in patients with refractory Crohn's disease resistant to induction (FLAMING).
Protocol code: ABM/FLAMING/2023
Sponsor: Wojskowy Instytut Medyczny Panstwowy Instytut Badawczy (Hospital/Clinic/Other health care facility). Phase: Therapeutic exploratory (Phase II). Countries: Poland (ongoing, recruiting).
Therapeutic area(s): Diseases [C] - Immune System Diseases [C20]; Diseases [C] - Digestive System Diseases [C06]
Gender: Female, Male. Age: 18-64 years, 65+ years. Enrolment: 192.
Status: Ongoing, recruiting. Start date (EU): 2025-04-18. Decision date: 2024-05-06. Results received: No. Last updated: 2026-07-10.

Condition(s): Crohn's disease
Product: USTEKINUMAB, USTEKINUMAB, USTEKINUMAB, USTEKINUMAB, VEDOLIZUMAB, INFLIXIMAB, INFLIXIMAB

Primary endpoint: Percentage of sustained corticosteroid-free remissions at week 52, sustained from week 8 onward with a maximum 11-week regimen of corticosteroids tapering. Clinical remission defined as an absolute CDAI score <150 points.
Endpoint(s): Percentage of clinical response at Week 8, Week 22 and Week 52, defined as CDAI-100 response,, i.e., a decrease in CDAI score of 100 points or more from the baseline value., Percentage of clinical response at Week 8, Week 22 and Week 52, defined as CDAI-70, i.e. a decrease in CDAI score of 70 points or more form the baseline value., Percentage of clinical remission at Week 8, defined as an absolute CDAI score of < 150 points., Percentage of deaths from Crohn’s disease at Week 8, Week 22 and Week 52. 5. The cumulative dose of corticosteroids used during the current flare of Crohn’s disease at Week 52., The cumulative dose of corticosteroids used during the current flare of Crohn’s disease at Week 52., Percentage of patients who achieved endoscopic remission at Week 8, Week 22 and Week 52 . Endoscopic remission is defined as (all conditions must be met): - SES-CD score ≤ 4 points and - SES-CD score with at least 2 points reduction from baseline value and - SES-CD subscores ≤ 1 point in all individual component., Percentage of patients who achieved an endoscopic response at Week 8, Week 22 and Week 52, defined as a 50% reduction in SES-CD score from baseline value., Change from baseline value in quality of life measured by SIBDQ, PROMIS-29 v.2.1, WPAI:GH v.2.2 and PSQI questionnaires, at Week 8, Week 22 and Week 52., Occurrence of severe adverse events at Week 8, Week 22 and Week 52., Occurrence of non-severe adverse events at Week 8, Week 22 and Week 52., Occurrence of death from any cause at Week 8, Week 22 and Week 52., Occurrence of MACE events, defined as cardiovascular death, non-fatal myocardial infarction or non-fatal stroke, at Week 8, Week 22 and Week 52., Occurrence of tuberculosis at Week 8, Week 22 and Week 52., Occurrence of hemiplegia at Week 8, Week 22 and Week 52.

Source: https://euclinicaltrials.eu/ctis-public/view/2023-506626-37-00